EU clinical trial 2024-519328-26-01: A first-in-human trial to evaluate safety, tolerability, and pharmacokinetics of single and multiple oral doses of Debio 1453P in healthy adults
Protocol code: Debio 1453-101
Sponsor: Debiopharm International S.A. (Pharmaceutical company). Phase: Human Pharmacology (Phase I)- First administration to humans. Countries: Belgium (ongoing, recruiting).
Therapeutic area(s): Diseases [C] - Bacterial Infections and Mycoses [C01]
Gender: Female, Male. Age: 18-64 years. Enrolment: 112.
Status: Ongoing, recruiting. Start date (EU): 2025-06-18. Decision date: 2025-06-03. Results received: No. Last updated: 2026-04-27.

Condition(s): Sexual Transmitted Infection (STI)

Source: https://euclinicaltrials.eu/ctis-public/view/2024-519328-26-01